EU clinical trial 2024-512951-18-00: Open-Label, Single Arm Phase II Trial Investigating the Efficacy, Safety and Quality of Life of Neoadjuvant Chemotherapy with Liposomal Irinotecan Combined with Oxaliplatin and 5-Fluorouracil/Folinic Acid Followed by Curative Surgical Resection in Patients with Hepatic Oligometastatic Adenocarcinoma of the Pancreas (HOLIPANC)
Protocol code: Uni-Koeln-4067
Sponsor: University Of Cologne (Educational Institution). Phase: Therapeutic exploratory (Phase II). Countries: Germany (temporarily halted).
Therapeutic area(s): Diseases [C] - Neoplasms [C04]
Gender: Female, Male. Age: 18-64 years, 65+ years. Enrolment: 150.
Status: Temporarily halted. Start date (EU): 2021-08-06. Decision date: 2024-09-18. Results received: No. Last updated: 2025-07-22.

Condition(s): Hepatic Oligometastatic Adenocarcinoma of the Pancreas
Product: FLUOROURACIL, Onivyde pegylated liposomal 4.3 mg/ml concentrate for dispersion for infusion, OXALIPLATIN, FOLINIC ACID

Primary endpoint: Overall survival after R0/R1 resection (OS-res) (only patients with R0/R1 resection)
Endpoint(s): R0/R1 resection rate after neoadjuvant chemotherapy, Overall Survival, Progression-free survival (PFS) after R0/R1 resection according to RECIST v1.1, Type, frequency and severity of adverse events with severity according to NCI CTCAE version 5.0 (neoadjuvant chemotherapy), Perioperative morbidity and mortality, HR-QoL according to EORTC QLQ-C30 and EORTC QLQ-PAN26 questionnaires, HR-QoL-adjusted OS

Source: https://euclinicaltrials.eu/ctis-public/view/2024-512951-18-00